EU clinical trial 2024-518898-34-00: A clinical study is aimed at comparing the effectiveness of two types of cell therapy in treating anal fistulas associated with Crohn's disease.
Protocol code: PB_A&A-ASC-FISTULA_1
Sponsor: Uniwersytet Jagiellonski Collegium Medicum (Educational Institution). Phase: Phase II and Phase III (Integrated). Countries: Poland (ongoing, recruiting).
Therapeutic area(s): Diseases [C] - Digestive System Diseases [C06]
Gender: Female, Male. Age: 18-64 years, 65+ years. Enrolment: 48.
Status: Ongoing, recruiting. Start date (EU): 2026-04-21. Decision date: 2025-01-30. Results received: No. Last updated: 2026-03-11.

Condition(s): Anal or recto-cutaneous or recto-vaginal Crohn-related fistula

Source: https://euclinicaltrials.eu/ctis-public/view/2024-518898-34-00